EU clinical trial 2022-501137-23-00: A Phase 2 Theranostic Trial Evaluating the Effects of Thiethylperazine in Patients Diagnosed with an Early Stage of Alzheimer's disease
Protocol code: IG-TEP-001
Sponsor: Immungenetics AG (Pharmaceutical company). Phase: Therapeutic exploratory (Phase II). Countries: Germany (authorised, recruitment pending).
Therapeutic area(s): Psychiatry and Psychology [F] - Mental Disorders [F03]
Gender: Female, Male. Age: 18-64 years, 65+ years. Enrolment: 228.
Status: Authorised, recruitment pending. Decision date: 2022-11-02. Results received: No. Last updated: 2025-12-08.

Condition(s): Newly diagnosed early-to-mild dementia due to Alzheimer's Disease
Product: lactose monohydrate (67.66 mg), corn starch (11.94 mg), magnesium stearate, talc, polyglycol 6000, sucrose (33.7 mg), calcium carbonate, titanium dioxide (E171), povidone 90 F, glycerol 85%, and montanglycol wax, Neuraceq 300 MBq/mL solution for injection, Torecan 6,5 mg obalené tablety

Primary endpoint: The 2 arms (TEP-THX vs. PBO-THX) will be compared as regards the mean change in Florbetaben-PET SUVR at month 12, adjusted for baseline
Endpoint(s): Area under the curve (AUC), sensitivity and specificity for TEP-aided diagnosis at baseline (AD-DX vs. DC-DX), Differences between the groups (TEP-THX vs. PBO-THX) as regards GFAP, p-Tau181, Aβ42/40 ratio and NfL biomarkers in plasma at month 12, adjusted for baseline, Differences between the groups (TEP-THX vs. PBO-THX) as regards Aβ42/40 ratio, p-Tau181/total Tau ratio, and NfL, at month 12, adjusted for baseline, Differences between the groups (TEP-THX vs. PBO-THX) as regards iADRS, ADCS-Cog 13, FCSRT, ADCS-iADL, QoL-AD, NPI-Q and GDS levels at month 12, adjusted for baseline

Source: https://euclinicaltrials.eu/ctis-public/view/2022-501137-23-00